EU clinical trial 2024-517899-38-00: EORTC-2361-GUCG: Phase II trial evaluating the efficacy of 177Lutetium-PSMA treatment in patients with metastatic clear cell Renal Carcinoma Cell with progressive disease on first-line or second-line systemic treatment (RENALUT)
Protocol code: EORTC-2361-GUCG
Sponsor: Europese Organisatie Voor Onderzoek En Behandeling Van Kanker Organisation Europeenne Pour La Recherche Et Le Traitement Du Cancer European Organi (Patient organisation/association). Phase: Therapeutic exploratory (Phase II). Countries: Spain (authorised, recruitment pending), France (ongoing, recruiting), Belgium (authorised, recruitment pending).
Therapeutic area(s): Diseases [C] - Neoplasms [C04]
Gender: Female, Male. Age: 18-64 years, 65+ years. Enrolment: 58.
Start date (EU): 2026-02-25. Decision date: 2025-08-18. Results received: No. Last updated: 2026-06-19.
Decision dates by country: FR: 2025-08-25, ES: 2025-08-20, BE: 2025-08-18

Condition(s): Clear Cell Renal Cell Carcinoma (ccRCC)
Product: Pluvicto 1 000 MBq/mL solution for injection/infusion

Primary endpoint: Objective Response, defined as Complete Response (CR) or Partial Response (PR) based on RECIST 1.1 criteria, on conventional imaging.
Endpoint(s): Safety in all treated patients using Common Terminology Criteria for Adverse Events (CTCAE) V5.0, DCR at 6 months, PFS, Time to start of next systemic treatment, OS

Source: https://euclinicaltrials.eu/ctis-public/view/2024-517899-38-00